EU clinical trial 2024-513093-22-00: A phase I of TG6050 in the treatment of patients with metastatic lung cancer
Protocol code: TG6050.01
Sponsor: Transgene (Pharmaceutical company). Phase: Human Pharmacology (Phase I)- First administration to humans. Countries: France (ended).
Therapeutic area(s): Diseases [C] - Neoplasms [C04]
Gender: Female, Male. Age: 18-64 years, 65+ years. Enrolment: 36.
Status: Ended. Start date (EU): 2023-03-27. End date (EU): 2025-06-23. Decision date: 2024-07-03. Results received: No. Last updated: 2025-06-19.

Condition(s): Non-small cell lung cancer (NSCLC)

Source: https://euclinicaltrials.eu/ctis-public/view/2024-513093-22-00